EU clinical trial 2024-511886-12-00: Sbrt±sTad for Unfavorable iNtermediate rIsk/high-risk prostate cancer (STUNNIN): A Randomized Phase II Study
Protocol code: 2020-004195-17
Sponsor: I.F.O. Istituti Fisioterapici Ospitalieri (Hospital/Clinic/Other health care facility). Phase: Therapeutic exploratory (Phase II). Countries: Italy (ongoing, recruiting).
Therapeutic area(s): Diseases [C] - Neoplasms [C04]
Gender: Male. Age: 18-64 years, 65+ years. Enrolment: 146.
Status: Ongoing, recruiting. Start date (EU): 2024-04-29. Decision date: 2024-04-29. Results received: No. Last updated: 2026-07-13.

Condition(s): Unfavorable intermediate/high risk prostate cancer patients
Product: BICALUTAMIDE

Primary endpoint: The primary objective of the study is 3-yr bNED survival.
Endpoint(s): Overall survival

Source: https://euclinicaltrials.eu/ctis-public/view/2024-511886-12-00